EU clinical trial 2023-507529-41-00: MK-1084 Single and Multiple Dose Healthy Participant Study
Protocol code: MK-1084-005
Sponsor: Merck Sharp & Dohme LLC (Pharmaceutical company). Phase: Human Pharmacology (Phase I)- Other. Countries: Belgium (ended).
Therapeutic area(s): Diseases [C] - Neoplasms [C04]
Gender: Female, Male. Age: 18-64 years. Enrolment: 27.
Status: Ended. Start date (EU): 2023-11-07. End date (EU): 2024-07-12. End date: 2024-07-13. Decision date: 2023-10-25. Results received: No. Last updated: 2024-03-13.

Condition(s): Solid tumor cancer and lung cancer

Source: https://euclinicaltrials.eu/ctis-public/view/2023-507529-41-00